EU clinical trial 2025-524060-38-00: An Early-Stage Study in Multiple Clinics of how Afimkibart May Affect the Body’s Processing of Medicines that Rely on Cytochrome P450 Enzymes in Patients with Ulcerative Colitis
Protocol code: GA46438
Sponsor: F. Hoffmann-La Roche AG (Pharmaceutical company). Phase: Human Pharmacology (Phase I)- Other. Countries: Germany (authorised, recruiting), Poland (ongoing, recruiting), Belgium (authorised, recruitment pending).
Therapeutic area(s): Diseases [C] - Digestive System Diseases [C06]
Gender: Female, Male. Age: 18-64 years. Enrolment: 19.
Start date (EU): 2026-05-28. Decision date: 2026-05-19. Results received: No. Last updated: 2026-07-27.
Decision dates by country: BE: 2026-05-20, DE: 2026-05-19, PL: 2026-05-20

Condition(s): Active Ulcerative Colitis (UC)

Source: https://euclinicaltrials.eu/ctis-public/view/2025-524060-38-00